EU clinical trial 2024-513940-27-00: A phase 2, multicenter, randomized, double blind, active controlled, parallel group study assessing the analgesic effect and safety of two doses of DFL24412 in patients with chronic low back pain compared to Ketoprofen Lysine Salt (KLS)
Sponsor: Dompe' Farmaceutici S.p.A. (Pharmaceutical company). Phase: Therapeutic exploratory (Phase II). Countries: Italy (ended), Spain (ended).
Therapeutic area(s): Diseases [C] - Musculoskeletal Diseases [C05]
Gender: Female, Male. Age: 18-64 years, 65+ years. Enrolment: 150.
Status: Ended. Start date (EU): 2021-11-19. End date (EU): 2024-12-30. Decision date: 2024-09-13. Results received: Yes. Last updated: 2024-09-16.
Decision dates by country: IT: 2024-09-16, ES: 2024-09-13

Condition(s): Chronic low back pain
Product: TACHIPIRINA 500 mg compresse, OKi 80 mg granulato per soluzione orale, KLS-GABA 40mg-17mg, KLS-GABA 80mg-34mg

Primary endpoint: • Change From Baseline in Average Daily Low Back Pain (LBP) Intensity as Measured by an 11-point Numeric Rating Scale (NRS) at Week 1
Endpoint(s): Change From Baseline in Average Daily Low Back Pain (LBP) Intensity as Measured by an 11-point Numeric Rating Scale (NRS) at the follow-up visit [Time Frame:, Day 21], Change from baseline in Neuropathic Pain Symptom Inventory (NPSI) score at week 1, Change from baseline in Douleur Neuropathique en 4 Questions (DN4) score at week 1, Change from baseline in Douleur Neuropathique en 4 Questions (DN4) score at the follow-up visit [ Time Frame: Day 21], Number of Participants Withdrawn Due to Lack of Efficacy Week 1, Change From Baseline in Roland-Morris Disability Questionnaire (RMDQ) Total Score at Week 1, Change from Baseline in Hospital Anxiety and Depression Scale (HADS) total score at Week 1, Patient Global Impression of Change (PGI-C) Score Week 1, Change From Baseline in European Quality of Life Questionnaire-5 Dimension-5 Level (EQ-5D-5L) to Week 1, Change From Baseline in Work Productivity and Activity Impairment (WPAI) Instrument at Week 1, Number of rescue interventions up to Week 1, Physical examination (see 7.1.2) [time frame: end of treatment visit (Week 1) or withdrawal]., Vital signs: blood pressure, heart rate and Body Temperature and ECG [time frame: end of treatment visit (Week 1) or early withdrawal]., Safety Laboratory Tests: hematocrit, hemoglobin, red blood cells, platelets, white blood cells, differential white blood cells count, sodium, potassium, calcium, serum creatinine, urea, serum albumin, total bilirubin, fractionated bilirubin, ALT, AST, ALP, lypases and amylases [time frame: end of treatment visit (Week 1) or early withdrawal]., Incidence of Adverse Events (AEs) and Serious Adverse Events (SAEs) [time frame: throughout the study].

Source: https://euclinicaltrials.eu/ctis-public/view/2024-513940-27-00